EU clinical trial 2024-515171-35-00: GETUG 20 : Phase III randomised trial to evaluate the benefit of adjuvant hormonal treatment with leuprorelin acetate (Eligard® 45 mg) for 24 months after radical prostatectomy in patients with high risk of recurrence
Protocol code: UC-0160/1003
Sponsor: Unicancer (Hospital/Clinic/Other health care facility). Phase: Therapeutic confirmatory (Phase III). Countries: France (ongoing, recruitment ended).
Therapeutic area(s): Diseases [C] - Neoplasms [C04]
Gender: Female, Male. Age: 18-64 years, 65+ years. Enrolment: 325.
Status: Ongoing, recruitment ended. Start date (EU): 2011-07-06. Decision date: 2024-09-10. Results received: No. Last updated: 2026-01-07.

Condition(s): Prostatic adenocarnicoma with high risk of recurrence
Product: ELIGARD 45 mg, poudre et solvant pour solution injectable

Primary endpoint: The principal criterion is the evaluation of effectiveness in terms of survival without metastases to 10 years, of adjuvant treatment with leuprorelin acetate (Eligard® 45 mg) for 24 months after radical prostatectomy. In case of biological reccurence, the presence of metastases will be evaluated with an abdominal-pelvic CT scan (or MRI) and bone scintigraphy.
Endpoint(s): Evaluation of PSA progression, Evaluation of testosterone level, Evaluation of specific survival, Evaluation of overall survival, Evaluation of tolerance to the treatment, Evaluation of quality of life (QLQ-C30 questionnaires)

Source: https://euclinicaltrials.eu/ctis-public/view/2024-515171-35-00